EU clinical trial 2023-504516-15-00: Bioequivalence of Tofacitinib 10 mg Film-Coated Tablets: A Single-Dose, Open-Label, Randomized, Two-Sequence, Two-Treatment, Two-Period Crossover Study in Healthy Subjects Under Fasting Conditions.
Protocol code: BLCL-TOF-EU-01
Sponsor: Bluepharma Industria Farmaceutica S.A. (Pharmaceutical company). Phase: Human Pharmacology (Phase I)- Bioequivalence Study. Countries: Portugal (ended).
Therapeutic area(s): Not possible to specify
Gender: Female, Male. Age: 18-64 years. Enrolment: 38.
Status: Ended. Start date (EU): 2023-12-18. End date (EU): 2024-01-26. Decision date: 2023-11-21. Results received: Yes. Last updated: 2024-01-26.

Condition(s): No medical condition.
Product: Tofacitinib, XELJANZ 10 mg film-coated tablets

Primary endpoint: Cmax and AUC0-t of Tofacitinib will be the primary pharmacokinetic parameters.
Endpoint(s): tmax, AUC0-∞, %AUCextrap, λz and t1/2 of Tofacitinib will be the secondary pharmacokinetic parameters., Occurrence of adverse events (AEs), including clinically relevant abnormalities from clinical laboratory tests and vital signs.

Source: https://euclinicaltrials.eu/ctis-public/view/2023-504516-15-00